EU clinical trial 2022-502404-73-00: A Phase II, Open-Label, Multicenter, Randomized Study of the Efficacy and Safety of Adjuvant Autogene Cevumeran Plus Atezolizumab and mFOLFIRINOX versus mFOLFIRINOX Alone in Patients with Resected Pancreatic Ductal Adenocarcinoma
Protocol code: GO44479
Sponsor: Genentech Inc. (Pharmaceutical company). Phase: Therapeutic exploratory (Phase II). Countries: Belgium (ongoing, recruiting), France (ongoing, recruiting), Germany (ongoing, recruiting), Sweden (ongoing, recruiting), Netherlands (ongoing, recruiting), Spain (ongoing, recruiting).
Therapeutic area(s): Diseases [C] - Neoplasms [C04]
Gender: Female, Male. Age: 18-64 years, 65+ years. Enrolment: 204.
Status: Ongoing, recruiting. Start date (EU): 2024-06-03. Decision date: 2023-12-19. Results received: No. Last updated: 2026-04-01.
Decision dates by country: NL: 2024-01-08, SE: 2023-12-20, FR: 2023-12-19, BE: 2023-12-19, DE: 2023-12-22, ES: 2024-01-08

Condition(s): Pancreatic ductal adenocarcinoma

Primary endpoint: 1. DFS after randomization
Endpoint(s): 1. OS after randomization, 2. DFS rates at 12, 24, and 36 months, 3. OS rates at 3 and 5 years, 4. Incidence and severity of adverse events, with severity determined according to National Cancer Institute's Common Terminology Criteria for Adverse Events version 5.0 (CTCAE v5.0) grading scale, 5. Change from baseline in targeted vital signs, 6. Change from baseline in targeted clinical laboratory test results

Source: https://euclinicaltrials.eu/ctis-public/view/2022-502404-73-00